EU clinical trial 2023-508260-30-01: SALVOVAR trial: A pragmatic randomized phase III trial to assess the utility of adjusting chemotherapy dose & dosing schedule with the SALVage weekly dose-dense regimen in patients with poor prognostic OVARian cancers based on the tumor unfavorable primary chemosensitivity and incomplete debulking surgery.
Protocol code: GINECO-OV130b
Sponsor: Arcagy Gineco (Laboratory/Research/Testing facility). Phase: Therapeutic confirmatory (Phase III). Countries: France (ongoing, recruiting), Italy (ongoing, recruiting), Netherlands (authorised, recruitment pending).
Therapeutic area(s): Diseases [C] - Neoplasms [C04]
Gender: Female. Age: 18-64 years, 65+ years. Enrolment: 145.
Start date (EU): 2024-07-30. Decision date: 2024-05-07. Results received: No. Last updated: 2026-08-04.
Decision dates by country: IT: 2024-10-30, NL: 2025-09-15, FR: 2024-05-07

Condition(s): Patients with poor prognostic OVARian cancers based on the tumor primary chemosensitivity and incomplete debulking surgery.
Product: Filgrastim HEXAL 30 MU/0.5 ml solution for injection or infusion in pre-filled syringe, CARBOPLATIN, BEVACIZUMAB, PACLITAXEL

Primary endpoint: - Percentage of patients operated with late complete debulking surgery after receiving 3 additional cycles of randomized chemotherapy (expected increase from 5% in the control arm to 20%)% in the experimental arm), - Overall survival improvement by 49% (HR = 0.61) in the whole population translating in an improvement in median OS from 20 months (control arm) to 32.8 months (experimental arm) with a 1:1 randomization
Endpoint(s): - Overall response rate according to RECIST V1.1 in the whole population (see appendix 4), - Progression-free survival in the whole population, - Percentage of patients treated with a subsequent maintenance treatment with a PARP inhibitor (%) in the whole population, - Progression-free survival and overall survival in these patients compared to those not treated with PARP inhibitor, - In the population of patients treated with bevacizumab: • Overall response rate according to RECIST V1.1 • Progression-free survival & overall survival according to RECIST V1.1 • Percentage of patients operated with a late complete debulking surgery (%), - Adverse events graded according to the NCI Common Terminology Criteria Adverse Event Version 5.0 (see appendix 3), - Quality of life questionnaires, - To determine the impact of patient beliefs, preferences and experiences on the decision-making process; endpoint: shared decision-making, - To determine the impact of the shared decision-making process on outcomes in the short- and medium-term; endpoints: satisfaction with care, satisfaction with decision, patient-doctor relationship, emotions, treatment beliefs, treatment adherence, and quality of life., - Percentage of patients with BRCA mutation (%), - Percentage of patients with BRCA wild-type HRD disease (%), - Percentage of patients with BRCA wild-type HRP disease (%), - Tests/assays used (names, proprietary), and percentage of each of them (%), - Incremental cost-utility ratio and incremental cost-effectiveness ratio, - Net financial impact over 5 years, - Percentage of patients operated with late complete debulking surgery, regardless of the number of chemotherapy cycles received

Source: https://euclinicaltrials.eu/ctis-public/view/2023-508260-30-01